EU clinical trial 2025-521570-34-00: A randomised, double-blind, three parallel-group, placebo controlled superiority trial assessing the effect of intravenous versus oral iron supplementation on physical performance, quality of life and cognitive function in iron deficient FRAIL elderly IndiviDuals with cardiovascular disease (FRAIL-ID trial)
Protocol code: 2024/ABM/01/00060
Sponsor: Wroclaw Medical University (Educational Institution). Phase: Therapeutic use (Phase IV). Countries: Poland (authorised, recruitment pending).
Therapeutic area(s): Diseases [C] - Nutritional and Metabolic Diseases [C18]
Gender: Female, Male. Age: 65+ years. Enrolment: 396.
Status: Authorised, recruitment pending. Decision date: 2026-06-05. Results received: No. Last updated: 2026-06-05.

Condition(s): Frailty with Iron Deficiency in Elderly Patients with Cardiovascular Disease
Product: 0,9% Sodium Chloride–Braun, 9 mg/ml, roztwór do infuzji, Tardyferon, 80 mg, tabletki powlekane o przedłużonym uwalnianiu, Ferinject 50 mg żelaza/ml dyspersja do wstrzykiwań/infuzji., Placebo w postaci tabletek powlekanych

Primary endpoint: Difference in SPPB values assessed at month 12 (at the end of the treatment period) and at baseline.
Endpoint(s): Difference in EQ-5D-5L scores assessed at month 12 (at the end of the treatment period) and at baseline, Total number of falls during the 12-month treatment period, Total number of days spent in hospital during the 12-month treatment period

Source: https://euclinicaltrials.eu/ctis-public/view/2025-521570-34-00